EU clinical trial 2024-518988-35-00: The pivotal bioequivalence study comparing the test product to the reference product, which belong to the group of medicines used in treatment of uncomplicated lower urinary tract infections.
Protocol code: SPh/01/2024
Sponsor: Sciencepharma Sp. z o.o. (Pharmaceutical company). Phase: Human Pharmacology (Phase I)- Bioequivalence Study. Countries: Czechia (ended).
Therapeutic area(s): Diseases [C] - Bacterial Infections and Mycoses [C01]
Gender: Female, Male. Age: 18-64 years. Enrolment: 34.
Status: Ended. Start date (EU): 2025-04-01. End date (EU): 2025-05-28. Decision date: 2025-03-31. Results received: No. Last updated: 2025-03-31.

Condition(s): Not applicable (submitted trial is a bioequivalence in healthy subjects)

Source: https://euclinicaltrials.eu/ctis-public/view/2024-518988-35-00